EU clinical trial 2026-525790-39-00: A study to investigate the repeat-dose pharmacokinetics of a combined oral contraceptive when given alone and in combination with ganfeborole in female participants of non-childbearing potential.
Protocol code: 308245
Sponsor: Glaxosmithkline Research & Development Limited (Pharmaceutical company). Phase: Human Pharmacology (Phase I)- Other. Countries: Spain (authorised, recruitment pending).
Therapeutic area(s): Diseases [C] - Bacterial Infections and Mycoses [C01]
Gender: Female. Age: 18-64 years, 65+ years. Enrolment: 28.
Status: Authorised, recruitment pending. Decision date: 2026-07-06. Results received: No. Last updated: 2026-07-16.
Decision dates by country: ES: 2026-07-16

Condition(s): Tuberculosis

Source: https://euclinicaltrials.eu/ctis-public/view/2026-525790-39-00